EU clinical trial 2024-515785-14-00: A clinical study of the V540A vaccine in healthy adults (V540A-001)
Protocol code: V540A-001
Sponsor: Merck Sharp & Dohme LLC (Pharmaceutical company). Phase: Human Pharmacology (Phase I)- First administration to humans. Countries: Belgium (ended).
Therapeutic area(s): Diseases [C] - Virus Diseases [C02]
Gender: Female, Male. Age: 18-64 years. Enrolment: 144.
Status: Ended. Start date (EU): 2024-10-22. End date (EU): 2026-05-22. Decision date: 2024-10-21. Results received: No. Last updated: 2026-05-08.
Decision dates by country: BE: 2025-01-17

Condition(s): Human Papilloma virus

Source: https://euclinicaltrials.eu/ctis-public/view/2024-515785-14-00